EU clinical trial 2024-516378-31-00: Phase II proof-of-concept, randomized, double-blind, placebo-controlled study to evaluate the efficacy and safety of plitidepsin in adults with post-COVID-19 Condition (PCC)
Protocol code: THALASSA 2.0
Sponsor: Fundacion Fls De Lucha Contra El Sida Las Enfermedades Infecciosas Y La Promocion De La Salud Y La Ciencia (Patient organisation/association). Phase: Therapeutic exploratory (Phase II). Countries: Spain (ongoing, recruitment ended).
Therapeutic area(s): Diseases [C] - Virus Diseases [C02]
Gender: Female, Male. Age: 18-64 years, 65+ years. Enrolment: 90.
Status: Ongoing, recruitment ended. Start date (EU): 2025-02-07. Decision date: 2024-12-05. Results received: No. Last updated: 2025-07-31.

Condition(s): post-COVID-19 Condition (PCC)
Product: PALONOSETRON, FAMOTIDINE, DEXAMETHASONE PHOSPHATE, Plitidepsin, DEXCHLORPHENIRAMINE, PLACEBO

Primary endpoint: Difference between groups on the PROMIS-29® health scale measured by T- Score on day 90 (±5) of the follow-up period* (after the intervention period).
Endpoint(s): Proportion of adverse events (AE, coded by MedDRA) comparing between groups at day 90 (±5) of the follow-up period, considering: 1) All AEs. 2) AEs grade 3 and 4 leading to discontinuation from the study. 3) AEs of special interest (AESI): cardiac, liver, acute-infusional reactions., Percentage of TEAEs detected on day 10 (±2), day 30 (±2), and day 90 (±5) of the follow-up period., Difference between groups on the PROMIS-29® health scale measured by T-Score on day 10 (±2), day 30 (±2), and day 90 (±5) of the follow-up period., Difference between groups in functional capacity on the PCFS scale on day 10 (±2), day 30 (±2), and day 90 (±5) of the follow-up period., Proportion of subjects with ≥10 points reduction in the Can Ruti Questionnaire scale on day 10 (±2), day 30 (±2), and day 90 (±5) of the follow-up period., Difference between groups according to the EuroQoL-5D questionnaire on day 10 (±2), day 30 (±2), and day 90 (±5) a of the follow-up period., Change from baseline in neuropsychological symptoms to day 10 (±2), day 30 (±2), and day 90 (±5) of the follow-up period, measured using the following questionnaires: Neu Screen (psychomotor speed and executive function); PHQ-9 (depressive symptoms); GAD-7 (anxiety symptoms); PSQI (Sleep quality); and WHODAS 2.0 (disability)., Change from baseline in physical activity to day 10 (±2), day 30 (±2), and day 90 (±5) of the follow-up period, assessed using the International Physical Activity Questionnaire (IPAQ)., Change from baseline in physical activity to day 10 (±2), day 30 (±2), and day 90 (±5) of the follow-up period, evaluated using the Fatigue Severity Scale (FSS) and the Five Times Sit-to-Stand Test (5xSTS)., Change from baseline in inflammation markers on day 10 (±2), day 30 (±2), and day 90 (±5) of the follow-up period., Change from baseline in immunological assessments (including autoimmunity) to day 10 (±2), day 30 (±2), and day 90 (±5) of the follow-up period., Change from baseline in viral components in plasma to day 10 (±2), day 30 (±2), and day 90 (±5) of the follow-up period., Change from baseline in thromboinflammatory and complement activation components in plasma to day 10 (±2), day 30 (±2), and day 90 (±5) of the follow-up period., Change from baseline in hormonal component alterations in plasma to day 10 (±2), day 30 (±2), and day 90 (±5) of the follow-up period., Exploratory Endpoint for future investigations: Change from baseline in intestinal microbiota in stool samples at Day 10 (±2), Day 30 (±2), and Day 90 (±5) of the follow-up period.

Source: https://euclinicaltrials.eu/ctis-public/view/2024-516378-31-00